EU clinical trial 2025-522118-21-00: Impact Of Upadacitinib On The Frequency Of Acute Recurrent Anterior Uveitis In Patients With Axial Spondyloarthritis (UP-FOR-U)
Protocol code: B25-723
Sponsor: Care Arthritis Ltd. (Educational Institution). Phase: Therapeutic use (Phase IV). Countries: Spain (authorised, recruitment pending), Poland (authorised, recruitment pending), Netherlands (authorised, recruitment pending), France (authorised, recruitment pending), Bulgaria (authorised, recruitment pending), Germany (authorised, recruitment pending).
Therapeutic area(s): Diseases [C] - Musculoskeletal Diseases [C05]; Diseases [C] - Eye Diseases [C11]
Gender: Female, Male. Age: 18-64 years, 65+ years. Enrolment: 130.
Status: Authorised, recruitment pending. Decision date: 2026-03-13. Results received: No. Last updated: 2026-03-23.
Decision dates by country: BG: 2026-03-13, FR: 2026-03-16, DE: 2026-03-13, ES: 2026-03-17, NL: 2026-03-16, PL: 2026-03-23

Condition(s): Acute Anterior Uveitis, Axial Spondyloarthritis
Product: RINVOQ 15 mg prolonged-release tablets

Primary endpoint: Change in exposure-adjusted opthalmologist (or optometrist or rheumatologist)-diagnosed AAU event rate per 100 patient years (EAER) over 52 weeks on upadacitinib compared to the AAU EAER in the 104 week pre-study period, separately in bDMARD-naive and bDMARD experienced groups.
Endpoint(s): Percentage of Participants Achieving Ankylosing Spondylitis Disease Activity Score Low Disease Activity (ASDAS LDA [< 2.1]) at week 24 in (i) bDMARD-IR (ii) bDMARD-naive groups, Percentage of participants Achieving Ankylosing Spondylitis Disease Activity Score Low Disease Activity (ASDAS LDA [< 2.1]) at weeks 24 and 52 in (i) bDMARD-IR; (ii) bDMARD-naive groups, Percentage of Participants Achieving Assessment of Spondyloarthritis International Society Health Index (ASAS-HI) Score of less than or equal to 5, up to week 52 in (i) bDMARD-IR; (ii) bDMARD-naive groups, Incidence of Adverse Events (AEs) and Adverse Events of Special Interest (AESIs), AEs and AESIs leading to withdrawal from study drug, and serious AEs (SAEs).

Source: https://euclinicaltrials.eu/ctis-public/view/2025-522118-21-00